EU clinical trial 2024-520045-23-00: A Phase 2 BIOmarker driven trial with Nivolumab and Ipilimumab or VEGFR tKi in naïve metastatic Kidney cancer
Sponsor: ARTIC (Patient organisation/association). Phase: Therapeutic exploratory (Phase II). Countries: France (authorised, recruitment pending).
Therapeutic area(s): Diseases [C] - Neoplasms [C04]
Gender: Female, Male. Age: 18-64 years, 65+ years. Enrolment: 200.
Status: Authorised, recruitment pending. Decision date: 2025-01-30. Results received: No. Last updated: 2026-02-13.

Condition(s): Kidney cancer
Product: IPILIMUMAB, NIVOLUMAB

Primary endpoint: Investigator-assessed ORR is defined as the proportion of randomized subjects who achieve a best overall response (BOR) of complete response (CR) or partial response (PR) using RECIST 1.1 criteria based on Investigator assessments.
Endpoint(s): Progression-free Survival The primary definition of PFS is specified as the time between randomization to the first date of documented progression, based on Investigator radiological assessments (as per RECIST 1.1 criteria), or death due to any cause, whichever occurs first. Subjects who die without a reported progression will be considered to have progressed on the date of their death., Overall Survival OS is defined as the time from randomization to the date of death from any cause. For subjects that are alive, their survival time will be censored at the date of last contact (“last known alive date”)., Objective response rate at 22 weeks ORR at 22 weeks as defined as percentage of patients with an objective response (decrease of SLD by at least 30%) at second CT or MRI after treatment initiation., Duration of treatment Duration of treatment (DOT) is defined as the time between treatment initiation and discontinuation for any reason or End of study., Duration of response Duration of response (DOR) is defined as the time between response to treatment and discontinuation for any reason or End of study., AE Incidence Rate The AE incident rate is defined as the proportion of subjects with any-grade AEs among subjects in each treatment arm. Events reported from the first dose, up to and including 100 days following the last dose of study treatment will be included in calculating this incidence rate

Source: https://euclinicaltrials.eu/ctis-public/view/2024-520045-23-00